EU clinical trial 2022-500345-25-00: C5041010 (APD334-207) An Open Label, Single Arm Study to Evaluate the Efficacy, Pharmacokinetics, and Safety of Etrasimod in Adolescent Participants with Moderately to Severely Active Ulcerative Colitis
Protocol code: APD334-207(C5041010)
Sponsor: Arena Pharmaceuticals Inc. (Pharmaceutical company). Phase: Therapeutic exploratory (Phase II). Countries: Spain (authorised, recruiting), Poland (ongoing, recruiting), Austria (authorised, recruiting), Belgium (authorised, recruiting), Slovakia (authorised, recruiting).
Therapeutic area(s): Diseases [C] - Digestive System Diseases [C06]
Gender: Female, Male. Age: 0-17 years. Enrolment: 19.
Start date (EU): 2023-01-16. Decision date: 2022-12-20. Results received: No. Last updated: 2026-06-18.
Decision dates by country: BE: 2023-11-09, AT: 2023-01-09, PL: 2023-01-09, SK: 2024-03-15, ES: 2022-12-20

Condition(s): Moderately to severely active ulcerative colitis
Product: PF-07915503, Etrasimod Arginine Blue, Etrasimod Arginine Blue

Primary endpoint: The proportion of participants achieving clinical remission by MMS at Week 52
Endpoint(s): The proportion of participants achieving clinical remission by MMS at Week 12, The proportion of participants achieving endoscopic improvement at Week 12, The proportion of participants achieving endoscopic improvement at Week 52, The proportion of participants achieving symptomatic remission at Week 12, The proportion of participants achieving symptomatic remission at Week 52, The proportion of participants with clinical remission at Week 12 and who had not been receiving corticosteroids for ≥ 2 weeks prior to Week 12, The proportion of participants with clinical remission at Week 52 and who had not been receiving corticosteroids for ≥ 12 weeks prior to Week 52, The proportion of participants achieving clinical response at Week 12, The proportion of participants achieving clinical response at Week 52, The proportion of participants achieving clinical remission by PUCAI at Week 12, The proportion of participants achieving clinical remission by PUCAI at Week 52, The proportion of subjects achieving a clinical response by PUCAI at Week 12, The proportion of subjects achieving a clinical response by PUCAI at Week 52, Etrasimod plasma C4h (concentration 4 hours post-dose), Etrasimod plasma steady state trough concentration (Ctrough,ss) at selected timepoints, Etrasimod steady state exposure area under plasma concentration-time over dosing interval (AUCτ) will be derived from a population PK post-hoc analysis, Incidence and severity of adverse events, Incidence and severity of laboratory abnormalities, and change from baseline in laboratory values (to include hematology, serum chemistry, coagulation, and urinalysis), Incidence of clinically significant vital sign abnormalities and changes from baseline

Source: https://euclinicaltrials.eu/ctis-public/view/2022-500345-25-00